EU clinical trial 2024-512537-33-00: A Phase III, Open-Label, Multicenter, Randomized Study Evaluating the Safety and Efficacy of Polatuzumab Vedotin in Combination with Rituximab Plus Gemcitabine Plus Oxaliplatin (R- GEMOX) Versus R- GEMOX Alone in Patients with Relapsed/Refractory Diffuse Large B-Cell Lymphoma
Protocol code: MO40598
Sponsor: F. Hoffmann-La Roche AG (Pharmaceutical company). Phase: Therapeutic confirmatory (Phase III). Countries: Italy (ended), Germany (ended), Spain (ended), France (ended), Greece (ended).
Therapeutic area(s): Diseases [C] - Neoplasms [C04]
Gender: Female, Male. Age: 18-64 years, 65+ years. Enrolment: 49.
Status: Ended. Start date (EU): 2019-11-28. End date (EU): 2024-07-23. End date: 2024-11-30. Decision date: 2024-07-04. Results received: Yes. Last updated: 2024-09-12.
Decision dates by country: FR: 2024-09-09, DE: 2024-07-08, GR: 2024-09-12, IT: 2024-07-08, ES: 2024-07-04

Condition(s): Relapsed/refractory diffuse large B-cell lymphoma (DLBCL)
Product: MabThera 500 mg concentrate for solution for infusion, Polivy 140 mg powder for concentrate for solution for infusion., GEMCITABINE, OXALIPLATIN

Primary endpoint: 1. Incidence, nature and severity of physical findings and AEs, with a specific focus on peripheral neuropathy, according to the NCI CTCAE v5.0 (Stage 1), 2. Overall survival (Stage 2)
Endpoint(s): 1. Incidence and assessment of peripheral neuropathy, as measured by Functional Assessment of Cancer Therapy/Gynecologic Oncology Group-Neurotoxicity 12-Item Scale (FACT-/GOG-NTX-12) (Stage 1), 2. Incidence, nature and severity of AEs (including peripheral neuropathy) according to NCI CTCAE v5.0 and physical findings (Stage 2), 3. Tolerability, as measured by dose interruptions, dose reductions and dose intensity (Stage 1 and 2), 4. Prevalence of ADAs to polatuzumab vedotin at baseline and incidence of ADAs during the study (Stage 1 and 2), 5. CR as determined by an independent review committee (IRC) (Stage 2), 6. CR as determined by investigator (Stage 1 and 2), 7. ORR as determined by an IRC (Stage 2), 8. ORR as determined by investigator (Stage 1 and 2), 9. BOR as determined by investigator (Stage 1 and 2), 10. PFS as determined by investigator (Stage 1 and 2), 11. OS (Stage 1), 12. Event-free survival (EFSeff ) as determined by investigator (Stage 1 and 2), 13. DOR as determined by investigator (Stage 2), 14. Time to deterioration in physical functioning and fatigue as measured by the European Organisation for the Research and Treatment of Cancer Quality-of-Life Questionnaire, Core 30 (Stage 2), 15. Time to progression in lymphoma symptoms as measured by the Functional Assessment of Cancer Therapy-Lymphoma subscale (Stage 2), 16. Change from baseline in peripheral neuropathy as measured by the FACT/GOG-NTX-12 subscale score (Stage 2)

Source: https://euclinicaltrials.eu/ctis-public/view/2024-512537-33-00